EU clinical trial 2023-509035-30-00: [HIBOU] : A phase I, single-center, randomized, double-blind, single-dose escalation, placebo-controlled clinical study to evaluate the safety, tolerability and pharmacokinetics of IMP21052 administered intravenously in three groups of healthy male and female volunteers
Protocol code: HIBOU-2023PBMD07
Sponsor: Direction Centrale Du Service De Sante Des Armees (Hospital/Clinic/Other health care facility). Phase: Human Pharmacology (Phase I)- First administration to humans. Countries: France (ended).
Therapeutic area(s): Diseases [C] - Pathological Conditions, Signs and Symptoms [C23]; Phenomena and Processes [G] - Musculoskeletal and Neural Physiological Phenomena [G11]; Diseases [C] - Disorders of Environmental Origin [C21]
Gender: Female, Male. Age: 18-64 years. Enrolment: 40.
Status: Ended. Start date (EU): 2024-01-18. End date (EU): 2024-12-16. Decision date: 2024-01-02. Results received: No. Last updated: 2024-07-30.

Condition(s): Antidote

Source: https://euclinicaltrials.eu/ctis-public/view/2023-509035-30-00